EU clinical trial 2024-515674-27-00: Dose Escalation Phase 1 Study of IOA-289 in combination with gemcitabine/nab-paclitaxel
Protocol code: IOA-289-102
Sponsor: iOnctura SA (Pharmaceutical company). Phase: Human Pharmacology (Phase I)- Other. Countries: Italy (ended).
Therapeutic area(s): Diseases [C] - Neoplasms [C04]
Gender: Female, Male. Age: 18-64 years, 65+ years. Enrolment: 16.
Status: Ended. Start date (EU): 2024-10-01. End date (EU): 2025-07-22. Decision date: 2024-09-17. Results received: No. Last updated: 2025-07-01.

Condition(s): metastatic pancreatic cancer

Source: https://euclinicaltrials.eu/ctis-public/view/2024-515674-27-00